EU clinical trial 2025-523575-36-00: A phase II trial evaluating treatment intensification with Ezabenlimab in patients with PD-L1–expressing, locally advanced head and neck squamous cell carcinoma (LA-HNSCC) with minimal residual disease (MRD) as detected by circulating tumor DNA (ctDNA) after curative-intent chemoradiation
Sponsor: Cliniques Universitaires Saint-Luc (Hospital/Clinic/Other health care facility). Phase: Therapeutic exploratory (Phase II). Countries: Belgium (authorised, recruitment pending).
Therapeutic area(s): Diseases [C] - Neoplasms [C04]
Gender: Female, Male. Age: 18-64 years, 65+ years. Enrolment: 160.
Status: Authorised, recruitment pending. Decision date: 2026-04-22. Results received: No. Last updated: 2026-04-22.

Condition(s): Locally advanced head and neck squamous cell carcinoma (LA-HNSCC)
Product: Ezabenlimab

Primary endpoint: EFS rate at 2-years in MRD-positive patients (interventional cohort) where EFS rate is defined as the proportion of patients who have not experienced any EFS event at 2 years after MRD assessment (i.e., after CRT).
Endpoint(s): Frequency and severity of TEAEs, irAEs, IRRs, serious AEs (SAE) TEAE/SAEs leading to dose delays, withdrawal or death. Clinically significant changes in laboratory, vital signs, and safety assessment parameters., Change from baseline in QoL as assessed by the EORTC QLQ-C30 and QLQ-HN43. Participant-reported frequency and severity of symptomatic toxicity based on PRO-CTCAE and FACT-GP5 and frequency distribution of PGIS/PGIC over time., Correlation of post-CRT ctDNA-based MRD status, ctDNA longitudinal changes (such as molecular response) with clinical activity and response. Change of ctDNA status (approx. every 3 months)., OS defined as the time from post-CRT MRD assessment to death from any cause., EFS is defined as the time from post-CRT MRD assessment to disease progression, recurrence, or death from any cause, whichever comes first

Source: https://euclinicaltrials.eu/ctis-public/view/2025-523575-36-00